EU clinical trial 2023-503188-40-00: An Open-label, Phase 3 Study to Evaluate the Pharmacokinetics, Safety, and Immunogenicity of Vedolizumab Subcutaneous in Pediatric Subjects With Moderately to Severely Active Ulcerative Colitis or Crohn’s Disease Who Achieved Clinical Response Following Open–label Vedolizumab Intravenous Therapy
Protocol code: VedolizumabSC-3003
Sponsor: Takeda Development Center Americas Inc. (Pharmaceutical company). Phase: Therapeutic confirmatory (Phase III). Countries: Portugal (ongoing, recruiting), Ireland (authorised, recruiting), Poland (ongoing, recruiting), Denmark (authorised, recruiting), Bulgaria (ongoing, recruiting), Netherlands (authorised, recruiting), Romania (ongoing, recruiting), Belgium (ongoing, recruiting), Spain (ongoing, recruiting), Italy (ongoing, recruiting).
Therapeutic area(s): Diseases [C] - Digestive System Diseases [C06]
Gender: Female, Male. Age: 0-17 years. Enrolment: 21243.
Start date (EU): 2025-01-06. Decision date: 2024-11-11. Results received: No. Last updated: 2026-06-03.
Decision dates by country: IE: 2024-11-15, BG: 2024-11-13, PT: 2024-11-12, PL: 2024-11-18, ES: 2024-11-15, DK: 2024-11-12, NL: 2024-11-14, BE: 2024-12-03, IT: 2024-11-12, RO: 2024-11-18

Condition(s): Active Ulcerative Colitis or Crohn’s Disease
Product: Entyvio 108 mg solution for injection in pre-filled syringe, Entyvio 300 mg powder for concentrate for solution for infusion

Primary endpoint: 01. Ctrough,ss: Steady-state Median Observed Plasma Concentration at the End of a Dosing Interval for Vedolizumab at Week 34 [Time Frame: Predose at Week 34], 02. Cavg,ss: Average Serum Concentration at Steady-state for Vedolizumab at Week 34 [Time Frame: Multiple time points prior to Week 34; pre-dose at Week 34]
Endpoint(s): 01. Percentage of Participants with Positive Antivedolizumab Antibody (AVA) [Baseline up to 18 weeks after last dose of study drug (up to Week 50)], 02. Percentage of Participants with Positive Neutralizing AVA [Baseline up to 18 weeks after last dose of study drug (up to Week 50)]

Source: https://euclinicaltrials.eu/ctis-public/view/2023-503188-40-00